EU clinical trial 2023-508824-36-00: QUANTITATIVE RENAL HYPERPOLARIZED [1-13C]PYRUVATE PERFUSION AND METABOLIC IMAGING IN DIABETIC KIDNEY DISEASE
Sponsor: Aarhus Universitet (Educational Institution). Phase: Therapeutic exploratory (Phase II). Countries: Denmark (ongoing, recruitment ended).
Therapeutic area(s): Phenomena and Processes [G] - Metabolism [G03]; Analytical, Diagnostic and Therapeutic Techniques and Equipment [E] - Diagnosis [E01]
Gender: Female, Male. Age: 18-64 years, 65+ years. Enrolment: 27.
Status: Ongoing, recruitment ended. Start date (EU): 2024-09-24. Decision date: 2024-02-29. Results received: No. Last updated: 2025-02-12.

Condition(s): Diabetic Kidney Disease
Product: Hyperpolarized [1-13C]pyruvate, GADOTERIC ACID

Primary endpoint: Metabolism and perfusion of kidney by hyperpolarised pyruvate
Endpoint(s): Glomerular Filtration Rate (Renography), reproducibility of hyperpolarised pyruvate MRI

Source: https://euclinicaltrials.eu/ctis-public/view/2023-508824-36-00